EU clinical trial 2023-508284-77-00: A Phase 3, Randomized, Double-blind, Placebo-controlled, Parallel, Multicenter Study to Evaluate the Safety and Efficacy of ALXN1720 in Adults with Generalized Myasthenia Gravis
Protocol code: ALXN1720-MG-301
Sponsor: Alexion Pharmaceuticals Inc. (Pharmaceutical company). Phase: Therapeutic confirmatory (Phase III). Countries: Portugal (ongoing, recruitment ended), France (ongoing, recruitment ended), Poland (ongoing, recruitment ended), Austria (ongoing, recruitment ended), Spain (ongoing, recruitment ended), Netherlands (ended), Germany (ongoing, recruitment ended), Denmark (ongoing, recruitment ended), Italy (ongoing, recruitment ended).
Therapeutic area(s): Diseases [C] - Nervous System Diseases [C10]
Gender: Female, Male. Age: 18-64 years, 65+ years. Enrolment: 92.
Start date (EU): 2022-11-16. Decision date: 2024-05-13. Results received: No. Last updated: 2026-04-30.
Decision dates by country: NL: 2024-05-13, PT: 2024-06-05, FR: 2024-05-21, IT: 2024-06-03, DK: 2024-05-13, PL: 2024-05-20, ES: 2024-05-14, DE: 2024-05-15, AT: 2024-05-21

Condition(s): Generalized Myasthenia Gravis with autoantibodies against acetylcholine receptor (AChR)
Product: ALXN1720 Placebo Product, Gefurulimab

Primary endpoint: Change From Baseline in Myasthenia Gravis-Activities of Daily Living (MG-ADL) Total Score at Week 26
Endpoint(s): Change From Baseline in Quantitative Myasthenia Gravis (QMG) Total Score at Week 26, Percentage of Responders Based on Reduction of the MG-ADL Total Score at Week 26, Percentage of Responders based on Reduction of the QMG Total Score at Week 26, Change From Baseline in Myasthenia Gravis Composite (MGC) Total Score at Week 26, Change from Baseline in the QMG total score at Week 4

Source: https://euclinicaltrials.eu/ctis-public/view/2023-508284-77-00